EU clinical trial 2025-521808-22-01: Effect of perioperative intravenous infusion of lidocaine on the postoperative course and the immune response in patients undergoing surgery for colon cancer - the PILDI study
Protocol code: ORI2025-16
Sponsor: Institute Of Oncology Ljubljana (Hospital/Clinic/Other health care facility). Phase: Therapeutic exploratory (Phase II). Countries: Slovenia (ongoing, recruiting).
Therapeutic area(s): Diseases [C] - Neoplasms [C04]
Gender: Female, Male. Age: 18-64 years, 65+ years. Enrolment: 100.
Status: Ongoing, recruiting. Start date (EU): 2026-02-03. Decision date: 2025-10-13. Results received: No. Last updated: 2026-03-04.

Condition(s): Colon cancer
Product: SODIUM CHLORIDE, LIDOCAINE HYDROCHLORIDE MONOHYDRATE

Primary endpoint: Total opioid analgesic consumption in both groups during the first 24 hours after the surgical procedure, expressed in mg.
Endpoint(s): Time to first postoperative bowel movement in patients of both groups (measured in hours from the end of the surgical procedure).

Source: https://euclinicaltrials.eu/ctis-public/view/2025-521808-22-01